EU clinical trial 2023-509694-22-00: A3921210 - OPEN-LABEL INDUCTION AND MAINTENANCE STUDY OF ORAL CP-690,550 (TOFACITINIB) IN CHILDREN WITH MODERATELY TO SEVERELY ACTIVE ULCERATIVE COLITIS
Protocol code: A3921210
Sponsor: Pfizer Inc. (Pharmaceutical company). Phase: Therapeutic confirmatory (Phase III). Countries: Netherlands (ongoing, recruitment ended), Italy (ongoing, recruitment ended), Spain (ended), Belgium (ongoing, recruitment ended), Poland (ongoing, recruitment ended), Germany (ended), France (ongoing, recruitment ended), Sweden (ongoing, recruitment ended), Hungary (ended), Finland (ended).
Therapeutic area(s): Diseases [C] - Digestive System Diseases [C06]
Gender: Female, Male. Age: 0-17 years. Enrolment: 37.
Start date (EU): 2022-01-26. Decision date: 2024-06-26. Results received: No. Last updated: 2026-04-02.
Decision dates by country: ES: 2024-07-16, FI: 2024-06-27, BE: 2024-06-28, FR: 2024-08-12, DE: 2024-06-27, HU: 2024-06-26, SE: 2024-06-27, NL: 2024-06-26, PL: 2024-07-10, IT: 2024-07-03

Condition(s): Ulcerative Colitis (UC)
Product: XELJANZ 1 mg/mL oral solution, XELJANZ 1 mg/mL oral solution, XELJANZ 1 mg/mL oral solution, Tofacitinib citrate, Tofacitinib citrate, XELJANZ 1 mg/mL oral solution

Primary endpoint: Remission by central read Mayo score following 44 weeks in the maintenance phase.
Endpoint(s): 1. Response by Mayo score (induction Week 8, induction Week 16, maintenance Week 44)., 2. Remission by Mayo score with local and central read (induction Week 8, induction Week 16), and with local read (maintenance Week 44)., 3. Change from baseline in Mayo score (induction Week 8, induction Week 16, maintenance Week 44)., 4. Partial Mayo Score response over time., 5. Change from baseline in partial Mayo scores over time., 6. Response by PUCAI score over time., 7. Remission by PUCAI score over time., 8. Change from baseline in PUCAI score over time., 9. Endoscopic improvement (previously known as mucosal healing) (induction Week 8, induction Week 16, maintenance Week 44)., 10. Endoscopic remission (induction Week 8, induction Week 16, maintenance Week 44)., 11. Remission at maintenance Week 44 (Mayo and PUCAI) and extension (PUCAI only) amongst participants who achieved remission at the end of Induction., 12. Rectal bleeding subscore of 0 over time., 13. Time to flare (maintenance, extension), 14. Change from baseline in fecal calprotectin levels over time., 15. Change from baseline in high sensitivity C-reactive protein (hs-CRP) levels over time., 16. Corticosteroid free remission by partial Mayo Score over time., 17. Change from baseline in lymphocyte subset counts (induction Week 8, induction Week 16, maintenance Week 44; extension Month 24)., 18. PK: plasma concentrations (baseline, induction Week 8, induction Week 16, maintenance Week 16, maintenance Week 44)., 19. Evaluation of taste acceptability of tofacitinib oral solution, and acceptability of film-coated tablet, if applicable, (Week 2).

Source: https://euclinicaltrials.eu/ctis-public/view/2023-509694-22-00